EU clinical trial 2024-513654-30-00: Phase 2 open label randomized study of radiotherapy, concomitant nimotuzumab and vinorelbine and re-irradiation at relapse versus radiotherapy and multiple elective radiotherapy courses with concomitant vinorelbine and nimotuzumab for newly diagnosed childhood and adolescence diffuse intrinsic pontine glioma (DIPG).
Protocol code: DIPG
Sponsor: Fondazione IRCCS Istituto Nazionale Dei Tumori (Hospital/Clinic/Other health care facility). Phase: Therapeutic exploratory (Phase II). Countries: Italy (ongoing, recruitment ended).
Therapeutic area(s): Diseases [C] - Neoplasms [C04]
Gender: Female, Male. Age: 0-17 years, 18-64 years. Enrolment: 81.
Status: Ongoing, recruitment ended. Start date (EU): 2015-11-04. Decision date: 2024-06-26. Results received: No. Last updated: 2024-06-26.

Condition(s): Diffuse intrinsic pontine glioma
Product: NIMOTUZUMAB, NAVELBINE 10 mg/ml concentrato per soluzione per infusione

Primary endpoint: Number of best responses (complete and partial responses) up to week 36 will be calculated in the conventional and experimental irradiation arms, and the comparison between the response rates will be performed
Endpoint(s): First progression of desease, first recurrence, secondary malignancy, death

Source: https://euclinicaltrials.eu/ctis-public/view/2024-513654-30-00